EU clinical trial 2024-517795-38-00: ERibulin in Advanced Solitary fibrous tumor, an ItaliaN sarcoma Group phase II study (ERASING)
Protocol code: ISG-ERASING
Sponsor: Italian Sarcoma Group (Patient organisation/association). Phase: Therapeutic exploratory (Phase II). Countries: Italy (ended).
Therapeutic area(s): Diseases [C] - Neoplasms [C04]
Gender: Female, Male. Age: 18-64 years, 65+ years. Enrolment: 20.
Status: Ended. Start date (EU): 2019-06-26. End date (EU): 2025-10-13. Decision date: 2024-10-01. Results received: No. Last updated: 2024-10-01.

Condition(s): Advanced Solitary fibrous tumor
Product: HALAVEN 0.44 mg/ml solution for injection, HALAVEN 0.44 mg/ml solution for injection, HALAVEN 0.44 mg/ml solution for injection, HALAVEN 0.44 mg/ml solution for injection, HALAVEN 0.44 mg/ml solution for injection, HALAVEN 0.44 mg/ml solution for injection, HALAVEN 0.44 mg/ml solution for injection, HALAVEN 0.44 mg/ml solution for injection

Primary endpoint: Overall tumor Response Rate, according to RECIST v 1.1
Endpoint(s): Choi Response Rate, Overall Survival (OS), Progression Free Survival (PFS), Clinical Benefit Rate, Duration of response, Safety

Source: https://euclinicaltrials.eu/ctis-public/view/2024-517795-38-00